EU clinical trial 2023-507274-40-00: A Phase 1 Open-Label Study Evaluating the Safety and Tolerability, and Pharmacokinetics of Navitoclax Monotherapy and in Combination with Ruxolitinib in Myeloproliferative Neoplasm Subjects, Incorporating Extension Part 6 – Continued Access for Navitoclax to Roll Over Subjects in France and Bulgaria from Studies M16-191 and M20-178
Protocol code: M19-753
Sponsor: AbbVie Deutschland GmbH & Co. KG (Pharmaceutical company). Phase: Human Pharmacology (Phase I)- Other. Countries: Bulgaria (ongoing, recruitment ended), Italy (ended), France (ongoing, recruitment ended), Spain (ended), Germany (ended), Croatia (ended).
Therapeutic area(s): Diseases [C] - Neoplasms [C04]
Gender: Female, Male. Age: 18-64 years, 65+ years. Enrolment: 60.
Start date (EU): 2021-04-22. Decision date: 2024-05-28. Results received: No. Last updated: 2026-02-19.
Decision dates by country: HR: 2024-05-29, DE: 2024-05-29, IT: 2024-06-03, ES: 2024-05-29, BG: 2024-05-29, FR: 2024-05-28

Condition(s): Myelofibrosis, Myeloproliferative Neoplasms
Product: Jakavi 10 mg tablets, CELECOXIB, Navitoclax, Navitoclax, Jakavi 10 mg tablets, Jakavi 5 mg tablets, Jakavi 5 mg tablets, Jakavi 5 mg tablets, Jakavi 10 mg tablets

Primary endpoint: Part 3: To evaluate the effect of navitoclax on corrected QTc interval by Fridericia's correction formula (QTcF) in subjects with MPN or CMML in the US and Europe., Part 4: To evaluate the effect of navitoclax, a potential CYP2C9 inhibitor, on the pharmacokinetics, safety, and tolerability of a single dose of celecoxib, a sensitive CYP2C9 substrate, in subjects with MPN or CMML., Part 5: To evaluate the effect of navitoclax on the PK, safety, and tolerability of ruxolitinib in subjects with MF in the US and Europe.
Endpoint(s): Safety Endpoint: Safety evaluations include adverse event (AE) monitoring, physical examinations, vital sign measurements, electrocardiogram (ECG) variables, and clinical laboratory testing (hematology, chemistry, coagulation, and urinalysis) as a measure of safety and tolerability, Pharmacodynamic Endpoint: Part 3 only- ECG variables will include QTcF, heart rate, PR interval (time from the onset of the P wave to the start of the QRS complex), QRS duration, and waveform composition., Pharmacokinetic Endpoint: Pharmacokinetic (PK) samples will be collected at specified time points and analyzed for navitoclax, Efficacy Endpoint: Preliminary efficacy will be evaluated.

Source: https://euclinicaltrials.eu/ctis-public/view/2023-507274-40-00